EU clinical trial 2023-508511-23-00: A Phase III, Randomized, Double-Blind, Placebo-Controlled, Multicenter Trial to Evaluate the Safety and Efficacy of AMX0035 Versus Placebo for 48-week Treatment of Adult Patients with Amyotrophic Lateral Sclerosis (ALS)
Protocol code: A35-004
Sponsor: Amylyx Pharmaceuticals Inc. (Pharmaceutical company). Phase: Therapeutic confirmatory (Phase III). Countries: Netherlands (ended), Poland (ended), Germany (ended), Ireland (ended), Belgium (ended), France (ended), Sweden (ended), Spain (ended), Portugal (ended), Italy (ended).
Therapeutic area(s): Diseases [C] - Nervous System Diseases [C10]
Gender: Female, Male. Age: 18-64 years, 65+ years. Enrolment: 526.
Status: Ended. Start date (EU): 2021-12-02. End date (EU): 2025-01-13. End date: 2025-01-14. Decision date: 2024-07-09. Results received: No. Last updated: 2024-08-04.
Decision dates by country: IE: 2024-07-09, BE: 2024-07-15, IT: 2024-07-22, SE: 2024-07-09, PT: 2024-07-12, PL: 2024-08-04, ES: 2024-07-17, DE: 2024-07-12, FR: 2024-07-16, NL: 2024-07-15

Condition(s): Amyotrophic Lateral Sclerosis (ALS)
Product: AMX0035, PL1 Oral powder in sachet, oral use

Primary endpoint: Change from baseline in ALSFRS-R total score at Week 48 adjusting for mortality
Endpoint(s): Change from baseline in ALSAQ-40 Total Score at Week 48, Overall survival, Change from baseline to Week 48 of the percent predicted SVC using in clinic visits, Change from baseline in ALSFRS-R total score at Week 24

Source: https://euclinicaltrials.eu/ctis-public/view/2023-508511-23-00